EU clinical trial 2025-523672-23-00: A phase 2 trial of BMS-986365 in mCSPC patients with suboptimal PSA-response after 7 months of Androgen Deprivation Therapy (ADT) plus Androgen Receptor Pathway Inhibition (ARPI).
Sponsor: UroTrials GmbH, AIO-Studien gGmbH (Laboratory/Research/Testing facility). Phase: Therapeutic exploratory (Phase II). Countries: Germany (authorised, recruitment pending).
Therapeutic area(s): Diseases [C] - Male Urogenital Diseases [C12]
Gender: Male. Age: 18-64 years, 65+ years. Enrolment: 42.
Status: Authorised, recruitment pending. Decision date: 2026-05-22. Results received: No. Last updated: 2026-06-10.
Decision dates by country: DE: 2026-06-10

Condition(s): Metastatic Castrate Sensitive Prostate Cancer - mCSPC
Product: BMS-986365

Primary endpoint: Confirmed PSA 50% response rate
Endpoint(s): Confirmed PSA 30 % and 90% response rate, Confirmed absolute PSA response rates (PSA ≤0.02, >0.02 – <0.2, ≥0.2-4.0 and >4.0 ng/ml), Time to PSA progression, Time to mCRPC, rPFS, Time to pain progression (TTPP), Time to symptomatic skeletal related event (TTSSE), Time to initiation of the first subsequent systemic therapy (TFST), The incidence of treatment emergent AEs (according to NCI-CTC AE 5.0), SAEs, AEs leading to dose modifications, interruptions, and discontinuation, ECG findings, and laboratory abnormalities and changes from baseline (including clinical chemistry and hematology parameters), Overall Survival, Change from baseline in NCCN FACT FPSI-17 total and subscale scores, Change from baseline in EQ-5D-5L, Change from baseline in BPI-SF, Analysis of AR copy number, splice variants and mutations at baseline, ctDNA detection rate at baseline, Changes in ctDNA from baseline during treatment

Source: https://euclinicaltrials.eu/ctis-public/view/2025-523672-23-00